EU clinical trial 2024-518817-24-01: Mannitol versus normal saline in brain death donors and recipients of kidney allograft on delayed graft function (MAVERICK) – A double-blinded, placebo-controlled randomized clinical trial
Sponsor: HUS-Yhtymae (Hospital/Clinic/Other health care facility). Phase: Therapeutic use (Phase IV). Countries: Finland (ongoing, recruiting).
Therapeutic area(s): Analytical, Diagnostic and Therapeutic Techniques and Equipment [E] - Therapeutics [E02]; Analytical,Diagnostic,Therapeutic Techniques and Equipment [E]-Surgical Procedures, Operative [E04]
Gender: Female, Male. Age: 18-64 years, 65+ years. Enrolment: 466.
Status: Ongoing, recruiting. Start date (EU): 2025-11-13. Decision date: 2025-04-07. Results received: No. Last updated: 2025-04-07.

Condition(s): End-stage renal disease. Kidney transplantation.
Product: MANNITOL

Primary endpoint: Days to kidney function (see trial protocol)
Endpoint(s): Delayed kidney graft function (DGF), Biopsy-proven acute kidney graft rejection within 3 months, Estimated glomerular filtration rate (eGFR) at 7 days, 1 month and 3 months

Source: https://euclinicaltrials.eu/ctis-public/view/2024-518817-24-01